EU clinical trial 2024-519830-22-00: (21467) A Phase 3, single-arm, open-label extension study to evaluate the safety of finerenone in addition to standard of care, in pediatric heart failure patients, from birth to 18 years of age, with left ventricular systolic dysfunction (LVSD)
Protocol code: 21467
Sponsor: Bayer AG (Pharmaceutical company). Phase: Therapeutic confirmatory (Phase III). Countries: Czechia (authorised, recruitment pending), Germany (authorised, recruitment pending), Greece (ongoing, recruiting), Italy (authorised, recruiting), Finland (authorised, recruiting), Bulgaria (authorised, recruiting), Belgium (ongoing, recruiting), Poland (authorised, recruiting), Austria (authorised, recruiting), Portugal (authorised, recruiting), Spain (authorised, recruitment pending), Hungary (authorised, recruiting), Sweden (authorised, recruiting).
Therapeutic area(s): Diseases [C] - Cardiovascular Diseases [C14]
Gender: Female, Male. Age: 0-17 years, 18-64 years. Enrolment: 61.
Start date (EU): 2026-04-27. Decision date: 2025-12-05. Results received: No. Last updated: 2026-06-26.
Decision dates by country: HU: 2025-12-10, BG: 2025-12-10, DE: 2025-12-08, GR: 2025-12-08, PT: 2025-12-05, ES: 2025-12-10, SE: 2025-12-05, PL: 2025-12-09, FI: 2025-12-08, CZ: 2025-12-09, IT: 2025-12-10, BE: 2025-12-09, AT: 2025-12-08

Condition(s): Heart failure due to systemic left ventricular systolic dysfunction
Product: Finerenone Bayer, Finerenone, Finerenone, BAY 94-8862

Primary endpoint: Number of participants with treatment emergent adverse events (TEAEs), Change in serum potassium levels from baseline to Day 270± 7 (Visit 6, EoT), Change in systolic blood pressure (SBP) from baseline to Day 270± 7 (Visit 6, EoT), Change in estimated glomerular filtration rate (eGFR) from baseline to Day 270± 7 (Visit 6, EoT)
Endpoint(s): Change in NT-proBNP from baseline to Day 270± 7 (Visit 6, EoT), Change in key echocardiographic parameters of left ventricular systolic function from baseline to Day 270± 7 (Visit 6, EoT), Maximum observed finerenone concentration in plasma after multiple doses (Cmax, md), Area under the curve for finerenone concentration in plasma after multiple doses (AUCτ,md), Taste and texture questionnaire of the pediatric formulation

Source: https://euclinicaltrials.eu/ctis-public/view/2024-519830-22-00